EU clinical trial 2022-502148-10-00: A multicenter, single arm, open-label trial to evaluate efficacy and safety of oral, twice daily iptacopan in adult PNH patients who have Hb≥10 g/dL in response to anti-C5 antibody and switch to iptacopan
Protocol code: CLNP023C12303
Sponsor: Novartis Pharma AG (Pharmaceutical company). Phase: Therapeutic confirmatory (Phase III). Countries: Spain (ended), Germany (ended), France (ended), Italy (ended).
Therapeutic area(s): Diseases [C] - Immune System Diseases [C20]
Gender: Female, Male. Age: 18-64 years, 65+ years. Enrolment: 25.
Status: Ended. Start date (EU): 2023-10-10. End date (EU): 2024-10-17. End date: 2024-10-18. Decision date: 2023-09-19. Results received: Yes. Last updated: 2024-06-19.
Decision dates by country: DE: 2023-09-20, FR: 2023-09-21, IT: 2023-09-19, ES: 2023-09-19

Condition(s): Paroxysmal Nocturnal Hemoglobinuria (PNH)
Product: IPTACOPAN

Primary endpoint: Measuring change in hemoglobin levels before start of iptacopan treatment and mean of hemoglobin levels at Day 126 and Day 168
Endpoint(s): Measuring change in hemoglobin levels before start of iptacopan treatment and mean of hemoglobin levels at Day 126 and Day 168

Source: https://euclinicaltrials.eu/ctis-public/view/2022-502148-10-00